EU clinical trial 2023-509568-81-00: A study of LOXO-783 in Patients with PIK3CA H1047R-Mutant Advanced Breast Cancer and Other Solid Tumors.
Protocol code: LOXO-PIK-21001
Sponsor: Eli Lilly & Co. (Pharmaceutical company). Phase: Human Pharmacology (Phase I)- First administration to humans. Countries: Belgium (ended), Italy (ended), Germany (ended), France (ended), Spain (ended).
Therapeutic area(s): Diseases [C] - Neoplasms [C04]
Gender: Female, Male. Age: 18-64 years, 65+ years. Enrolment: 100.
Status: Ended. Start date (EU): 2023-07-27. End date (EU): 2026-07-30. Decision date: 2024-07-08. Results received: No. Last updated: 2025-12-17.
Decision dates by country: DE: 2024-07-09, IT: 2024-07-10, BE: 2024-07-08, ES: 2024-07-10, FR: 2024-07-10

Condition(s): Advanced Breast Cancer and Other Solid Tumors

Source: https://euclinicaltrials.eu/ctis-public/view/2023-509568-81-00